EU clinical trial 2024-519876-17-00: Immune response to intradermally administered Ixiaro in healthy adults
Protocol code: Ixiaro i.d. - IdIx
Sponsor: HUS-Yhtymae (Hospital/Clinic/Other health care facility). Phase: Therapeutic use (Phase IV). Countries: Finland (authorised, recruitment pending).
Therapeutic area(s): Diseases [C] - Virus Diseases [C02]
Gender: Female, Male. Age: 18-64 years. Enrolment: 240.
Status: Authorised, recruitment pending. Decision date: 2025-01-10. Results received: No. Last updated: 2025-01-10.

Condition(s): 18-64 years old volunteers with general good health
Product: IXIARO suspension for injection Japanese encephalitis vaccine (inactivated, adsorbed)

Primary endpoint: Measurement of levels of neutralizing serum antibodies (PRNT)..
Endpoint(s): -To study circulating plasmablasts (ELISPOT) and cell-mediated immuneresponses after intradermal vs. intramuscular Ixiaro. - To study adverse event profiles

Source: https://euclinicaltrials.eu/ctis-public/view/2024-519876-17-00